EU clinical trial 2024-520062-54-00: A Phase 2b Randomized, Open-Label Study to Evaluate the Efficacy and Safety of Tobevibart+Elebsiran Combination Therapy versus Bulevirtide in Participants with Chronic HDV Infection (ECLIPSE 3)
Protocol code: VIR-CHDV-V206
Sponsor: Vir Biotechnology Inc. (Pharmaceutical company). Phase: Therapeutic exploratory (Phase II). Countries: Bulgaria (ongoing, recruitment ended), Italy (ended), Netherlands (ongoing, recruitment ended), Germany (ongoing, recruitment ended), Belgium (ongoing, recruitment ended), Spain (ongoing, recruitment ended), Romania (ongoing, recruitment ended), France (ongoing, recruitment ended).
Therapeutic area(s): Diseases [C] - Virus Diseases [C02]
Gender: Female, Male. Age: 18-64 years, 65+ years. Enrolment: 42.
Start date (EU): 2025-07-23. Decision date: 2025-06-11. Results received: No. Last updated: 2026-02-12.
Decision dates by country: DE: 2025-06-13, BG: 2025-06-16, RO: 2025-06-16, IT: 2025-06-13, BE: 2025-06-11, ES: 2025-06-11, NL: 2025-06-11, FR: 2025-06-16

Condition(s): Chronic Hepatitis D Virus (HDV) Infection
Product: HEPCLUDEX 2 mg powder for solution for injection, VIR-2218, VIR-3434

Primary endpoint: HDV RNA < Lower Limit of Quantification (LLOQ), Target Not Detected (TND) at Week 48 (Part 1), Part 2: HDV RNA < LLOQ, TND 24 weeks after end of treatment interruption (Week 120), Primary safety – Incidence of TEAEs and SAEs through Week 48
Endpoint(s): • HDV RNA < LLOQ at Week 48 • Change from baseline in HDV RNA at Week 48, Change from baseline in ALT at Week 48, Change from baseline in liver stiffness as measured by liver elastography at Week 48, • Incidence of decompensated cirrhosis (clinical event or CPT score ≥ 7) by Week 48 • Incidence of HCC and progression to liver failure requiring transplantation or resulting in death by Week 48, • Change from baseline in HBsAg at Week 48 • Categorical summary of HBsAg at Week 48, • HDV RNA < LLOQ, TND at Week 96, Week 120, Week 144, Week 192 and Week 240 • HDV RNA < LLOQ at Week 96, Week 120, Week 144, Week 192 and Week 240 • Change from baseline in HDV RNA at Week 96, Week 120, Week 144, Week 192 and Week 240 • Change from baseline in HDV RNA from tobevibart+elebsiran interruption at Week 96 to Week 120, Week 144, Week 192 and Week 240, •Change from baseline in ALT at Week 96, Week 120, Week 144, Week 192 and Week 240 • Change from baseline in ALT from tobevibart+elebsiran interruption at Week 96 to Week 120, Week 144, Week 192 and Week 240, • Change from baseline in liver stiffness as measured by liver elastography at Week 96, Week 144, Week 192 and Week 240, • Incidence of decompensated cirrhosis (clinical event or CPT score ≥ 7) by Week 96, Week 120, Week 144, Week 192 and Week 240 • Incidence of HCC and progression to liver failure requiring transplantation or resulting in death by Week 96, Week 120, Week 144, Week 192 and Week 240, • Categorical summary of HBsAg at Week 96, Week 120, Week 144, Week 192 and Week 240 • Change from baseline in HBsAg at Week 96, Week 120, Week 144, Week 192 and Week 240, • Incidence of TEAEs and SAEs through Week 96, Week 120, Week 144, Week 192 and Week 240 (secondary safety), • Incidence of AEs, SAEs and lab abnormalities from time of tobevibart+elebsiran interruption (Week 96) through Week 120, Week 144, Week 192 and Week 240 (secondary safety)

Source: https://euclinicaltrials.eu/ctis-public/view/2024-520062-54-00